EU clinical trial 2023-507233-19-00: A Phase 2/3, Multicenter, Open‑label Trial to Evaluate the Long‑term Safety, Tolerability, and Efficacy of Sibeprenlimab Administered Subcutaneously in Subjects with Immunoglobulin A Nephropathy.
Protocol code: 417-201-00012
Sponsor: Otsuka Pharmaceutical Development & Commercialization Inc. (Pharmaceutical company). Phase: Phase II and Phase III (Integrated). Countries: Spain (ongoing, recruiting), Belgium (ongoing, recruiting), Croatia (ongoing, recruiting), Czechia (ongoing, recruiting), France (ongoing, recruiting), Germany (ongoing, recruiting), Greece (ongoing, recruiting), Hungary (ongoing, recruiting), Italy (ongoing, recruiting), Portugal (ongoing, recruiting), Netherlands (ongoing, recruiting), Poland (ongoing, recruiting).
Therapeutic area(s): Diseases [C] - Male Urogenital Diseases [C12]; Diseases [C] - Immune System Diseases [C20]; Diseases [C] - Female Urogenital Diseases and Pregnancy Complications [C13]
Gender: Female, Male. Age: 18-64 years, 65+ years. Enrolment: 95.
Status: Ongoing, recruiting. Start date (EU): 2023-02-16. Decision date: 2023-10-31. Results received: No. Last updated: 2026-07-29.
Decision dates by country: BE: 2024-09-04, HR: 2024-09-22, FR: 2024-09-09, DE: 2024-09-03, GR: 2024-09-17, HU: 2024-09-03, IT: 2024-09-16, NL: 2024-09-12, PL: 2024-09-22, PT: 2024-09-23, CZ: 2024-09-19, ES: 2023-10-31

Condition(s): Treatment of IgAN
Product: Sibeprenlimab

Primary endpoint: Safety and tolerability: Incidence of TEAEs graded by severity and as assessed by clinical laboratory tests, vital sign measurements, physical examinations, and injection site reactions.
Endpoint(s): The slope of eGFR over the course of approximately 12 and 24 months., Mean change of eGFR from baseline at 12 and 24 months., Overall rate of proteinuric remission, based on 24-hour urine collection, and defined as the proportion of subjects achieving urine total protein < 0.5 g/day at 12 and 24 months., Relative change from baseline in terms of uPCR at 12 and 24 months, based on 24-hour urine collection., Progression to CKF, as assessed by: - Time to progression to CKF (time from first IMP date to first occurrence of CKF). - Proportion of subjects with progression to CKF., Pharmacodynamics: Change from baseline in total serum IgA, IgG, and IgM concentrations., Other: Evaluation of serum ADA levels., Estimate the time-normalized AUC for eGFR at 12 and 24 months.

Source: https://euclinicaltrials.eu/ctis-public/view/2023-507233-19-00